EU clinical trial 2024-515908-39-00: Evaluation of the Efficacy and the Safety of FOLFIRINOX3 Bevacizumab Treatment in patients with colorectal cancer
Protocol code: 2018-001452-36
Sponsor: Centr Georges Francois Leclerc (Hospital/Clinic/Other health care facility). Phase: Phase I and Phase II (Integrated)- Other. Countries: France (ongoing, recruitment ended).
Therapeutic area(s): Diseases [C] - Digestive System Diseases [C06]
Gender: Female, Male. Age: 18-64 years, 65+ years. Enrolment: 48.
Status: Ongoing, recruitment ended. Start date (EU): 2018-10-29. Decision date: 2024-08-02. Results received: No. Last updated: 2024-08-02.

Condition(s): Patients with metastatic colorectal cancer

Source: https://euclinicaltrials.eu/ctis-public/view/2024-515908-39-00